EU clinical trial 2024-511621-64-00: A randomized, multi-centric, placebo-controlled, participant and investigator-blinded study to evaluate the safety, tolerability and efficacy of TIN816 in adult patients at risk for acute kidney injury following cardiac surgery
Protocol code: CTIN816A12201
Sponsor: Novartis Pharma AG (Pharmaceutical company). Phase: Therapeutic exploratory (Phase II). Countries: Spain (ended), Germany (ended), Czechia (ended), Belgium (ended), Estonia (ended), France (ended), Hungary (ended).
Therapeutic area(s): Diseases [C] - Cardiovascular Diseases [C14]
Gender: Female, Male. Age: 18-64 years, 65+ years. Enrolment: 92.
Status: Ended. Start date (EU): 2023-01-18. End date (EU): 2025-06-12. End date: 2025-06-23. Decision date: 2024-08-06. Results received: Yes. Last updated: 2025-04-16.
Decision dates by country: ES: 2024-08-12, DE: 2024-08-09, HU: 2024-08-06, CZ: 2024-08-08, EE: 2024-08-08, FR: 2024-08-23, BE: 2024-08-09

Condition(s): Acute kidney injury
Product: TIN816, Placebo to TIN816 70mg powder for solution for injection or infusion

Primary endpoint: Ratio of the highest serum creatinine value (up to and including Study Day 6) versus baseline
Endpoint(s): Safety based on vital signs, physical examination, ECGs, laboratory assessments and collection of AEs assessed from baseline until the end of the study visit, AKI stages 1, 2 and 3 as defined by modified AKI Network (AKIN) criteria for serum creatinine, Anti-drug antibodies against TIN816, Occurrence of major adverse kidney events at day 30 (MAKE30) and day 90 (MAKE90) Occurrence of individual components of the MAKE criteria at Days 30 or 90.

Source: https://euclinicaltrials.eu/ctis-public/view/2024-511621-64-00